EU clinical trial 2023-507355-30-00: Optimizing subcutaneous FEntanyl titRation: RApid achievement of adequate exposure when treating cancer-Related paIn (FERRARI-study).
Sponsor: Erasmus Universitair Medisch Centrum Rotterdam (Erasmus MC) (Hospital/Clinic/Other health care facility). Phase: Therapeutic use (Phase IV). Countries: Netherlands (authorised, recruitment pending).
Therapeutic area(s): Diseases [C] - Neoplasms [C04]
Gender: Female, Male. Age: 18-64 years, 65+ years. Enrolment: 45.
Status: Authorised, recruitment pending. Decision date: 2023-11-10. Results received: No. Last updated: 2023-12-14.

Condition(s): Cancer pain

Source: https://euclinicaltrials.eu/ctis-public/view/2023-507355-30-00